EU clinical trial 2025-523567-38-00: Beamion 44: A randomized, open-label, multi-center Phase IIa platform trial to evaluate the safety and tolerability of zongertinib plus Pt-doublet with or without pembrolizumab (and potential other combinations) in treatment-naïve patients with locally advanced/metastatic non-squamous NSCLC with activating HER2 mutations
Protocol code: 1479-0044
Sponsor: Boehringer Ingelheim International GmbH, Boehringer Ingelheim Espana S.A. (Pharmaceutical company). Phase: Therapeutic exploratory (Phase II). Countries: Germany (ongoing, recruiting), France (ongoing, recruiting), Spain (ongoing, recruiting).
Therapeutic area(s): Diseases [C] - Neoplasms [C04]
Gender: Female, Male. Age: 18-64 years, 65+ years. Enrolment: 19.
Status: Ongoing, recruiting. Start date (EU): 2026-06-02. Decision date: 2026-05-19. Results received: No. Last updated: 2026-05-22.
Decision dates by country: FR: 2026-05-19, DE: 2026-05-19, ES: 2026-05-22

Condition(s): locally advanced or metastatic NSCLC
Product: Pemetrexed EVER Pharma 25 mg/ml concentrate for solution for infusion, BI 1810631, Cisplatin Hikma 1 mg/ml Konzentrat zur Herstellung einer Infusionslösung, Carboplatin Hikma 10 mg/ml Konzentrat zur Herstellung einer Infusionslösung, KEYTRUDA 25 mg/mL concentrate for solution for infusion.

Primary endpoint: Occurrence of discontinuation and/or prolonged interruption (>7 days) of zongertinib due to treatment-related AEs in the first 2 cycles of treatment
Endpoint(s): Occurrence of SAE during the on-treatment period, Occurrence of dose reduction of zongertinib, Occurrence of discontinuation and/or prolonged interruption (>7 days) of zongertinib due to treatment-related AEs during the on-treatment period, Occurrence of Grade ≥3 non-hematological AE during the on-treatment period, Occurrence of combination limiting toxicities (CLTs) during the on-treatment period, Objective response (OR) according to RECIST 1.1 as assessed by the investigator, defined as best overall response of confirmed complete response (CR) or confirmed partial response (PR) from date of randomization until the earliest of disease progression, death, or last evaluable tumor assessment before start of subsequent anti-cancer therapy, loss to follow-up or withdrawal of consent, Time to OR, defined as the time from date of randomization to first documented confirmed CR or PR among patients with OR as determined by investigator assessment per RECIST 1.1, Duration of OR (DoR), defined as the time from first documented confirmed CR or PR until disease progression or death among patients with OR as determined by investigator assessment per RECIST 1.1, Progression-free survival (PFS), defined as the time from randomization until tumor progression according to RECIST 1.1 as assessed by the investigator, or death from any cause, whichever occurs earlier, Time on treatment (ToT), defined as the time from first dose of study treatment until zongertinib treatment discontinuation or death

Source: https://euclinicaltrials.eu/ctis-public/view/2025-523567-38-00